EU clinical trial 2023-509241-12-00: B3461114- A Phase 1, Open-Label, Randomized, Three-Treatment, Three-Period, Crossover, Single Dose Study to Estimate the Relative Bioavailability of 61 mg and 70 mg Tafamidis Free Acid Tablets to Commercial 61 mg Tafamidis Free Acid Capsule Administered Under Fasted Conditions in Healthy Adult Participants
Protocol code: B3461114
Sponsor: Pfizer Inc. (Pharmaceutical company). Phase: Human Pharmacology (Phase I)- Other. Countries: Belgium (ended).
Therapeutic area(s): Diseases [C] - Musculoskeletal Diseases [C05]
Gender: Female, Male. Age: 18-64 years, 65+ years. Enrolment: 12.
Status: Ended. Start date (EU): 2024-02-15. End date (EU): 2024-05-27. End date: 2024-05-28. Decision date: 2024-02-12. Results received: Yes. Last updated: 2024-02-12.

Condition(s): aransthyretin amyloid cardiomyopathy
Product: Tafamidis round 2, Tafamidis round 1, Tafamidis oblong

Primary endpoint: AUCinf (if data permit, otherwise AUClast) and Cmax of tafamidis.

Source: https://euclinicaltrials.eu/ctis-public/view/2023-509241-12-00